EU clinical trial 2024-519894-20-01: RIFAMAB : Rifabutin versus rifampicin for treatment of staphylococcal prosthetic joint infection treated with debridement, antibiotics and implant retention (DAIR strategy): a multicenter randomized, open-label, non-inferiority trial
Protocol code: RIPH_2019_01
Sponsor: Centre Hospitalier De Tourcoing (Hospital/Clinic/Other health care facility). Phase: Therapeutic confirmatory (Phase III). Countries: France (authorised, recruiting).
Therapeutic area(s): Diseases [C] - Bacterial Infections and Mycoses [C01]
Gender: Female, Male. Age: 18-64 years, 65+ years. Enrolment: 436.
Status: Authorised, recruiting. Start date (EU): 2025-02-07. Decision date: 2025-02-07. Results received: No. Last updated: 2025-02-07.

Condition(s): Adult with an staphylococcal prosthetic joint infection treated with debridement, antibiotics and implant retention (DAIR strategy)
Product: RIFADINE 300 mg, gélule, ANSATIPINE 150 mg, gélule

Primary endpoint: The primary outcome is treatment failure after one year of follow-up, defined as one of following events: - The need for any further surgical procedure – i.e. implants removal, implants exchange or amputation; - And/or PJI related death; - And/or use of suppressive antibiotic therapy that was not planned before randomization
Endpoint(s): Proportion of patient which are free from SAEs occurrence, as defined by: o Patients who completed the entire 12 weeks’ duration of antibiotic treatment planned initially and; • Who did not experience grade 3-4 adverse events, including death, regardless of the link with antibiotic therapy; • Who did not experience adverse events which led to either to: • Reduce the dosage or split the treatment to two take/day; • Or stop any component of the antibiotic treatment., Number and rate of patients in each arm who experiences: o Liver cytolysis (>=2N for ALT AND/OR AST) o Acute Kidney failure as defined by serum creatinine increase in KDIGO o Digestive symptoms, including diarrhea o Who required a modification of antibiotic dosage during the 12 weeks’ period of antibiotic treatment o Uveitis/ophthalmologic disorder o Neurological disorder, Early termination rate will be measured in each arm, as the number of patients having stopped rifampicin or rifabutin before the planned 12 weeks’ period over the total number of patients enrolled in the studied arm., Adherence rate to medication will be measured as the number of days on which all doses were missed over the number of days of planned antibiotic therapy. Patients enrolled in the study will have to fill their pill count in a daily notebook., Quality of life, as evaluated by the use EQ5D5L auto-questionnaire at week 6, month 6, month 12 and month 24 as used in previous randomized clinical trial on bone and joint infection., Oxford Hip and Knee Scores evolution between week 6, month 6, month 12 and month 24 as used in previous randomized clinical trial on bone and joint infection., Long term efficacy: treatment failure, as defined for primary outcome, occurring between 12 months and 24 months after initial surgery.

Source: https://euclinicaltrials.eu/ctis-public/view/2024-519894-20-01